EU clinical trial 2024-511194-29-00: A Phase I, randomized, double-blind, multi-centre, placebo-controlled, dose-escalation study to evaluate the safety, reactogenicity and immunogenicity of AstriVax’ investigational vaccine for the prevention of yellow fever (AVX70120), and of AstriVax’ investigational vaccine for the prevention of rabies (AVX70481), in healthy adults aged 18 to 40 years.
Protocol code: AVX1248-101
Sponsor: AstriVax (Pharmaceutical company). Phase: Human Pharmacology (Phase I)- First administration to humans. Countries: Belgium (ended).
Therapeutic area(s): Diseases [C] - Virus Diseases [C02]
Gender: Female, Male. Age: 18-64 years. Enrolment: 144.
Status: Ended. Start date (EU): 2024-06-16. End date (EU): 2026-01-26. Decision date: 2024-06-13. Results received: No. Last updated: 2025-04-23.

Condition(s): Yellow fever, Rabies

Source: https://euclinicaltrials.eu/ctis-public/view/2024-511194-29-00